EU clinical trial 2022-500186-27-00: An open-label, multi-center, non-randomized pivotal Phase 3 study to evaluate the efficacy and safety of [18F]florbetaben Positron Emission Tomography (PET) imaging to diagnose cardiac AL amyloidosis
Protocol code: FBB-02-01-21a
Sponsor: Lantheus Germany GmbH (Pharmaceutical company). Phase: Therapeutic confirmatory (Phase III). Countries: Spain (ended), Germany (ended).
Therapeutic area(s): Diseases [C] - Cardiovascular Diseases [C14]; Analytical, Diagnostic and Therapeutic Techniques and Equipment [E] - Diagnosis [E01]
Gender: Female, Male. Age: 18-64 years, 65+ years. Enrolment: 169.
Status: Ended. Start date (EU): 2023-01-11. End date (EU): 2026-05-05. Decision date: 2022-08-24. Results received: No. Last updated: 2026-05-08.
Decision dates by country: DE: 2022-09-19, ES: 2022-08-29

Condition(s): ATTR Amyloidosis, AL Amyloidosis, Cardiac Amyloidosis
Product: Neuraceq 300 MBq/mL solution for injection

Primary endpoint: The co-primary efficacy variables will be the sensitivity and specificity of the visual assessment of [18F]florbetaben PET images for the diagnosis of cardiac AL amyloidosis
Endpoint(s): The sensitivity and specificity of [18F]florbetaben PET for the diagnosis of cardiac AL amyloidosis will be determined by using quantitative image analysis, Correlation of quantitative [18F]florbetaben PET results with left ventricular ejection fraction (LV EF) and left ventricular mass (LV mass), Correlation of quantitative [18F]florbetaben PET results with AL-CA prognostic values (Mayo stage I – IV) based on FLC-diff, cTnT and NT-proBNP levels., The impact of PET imaging (AL-CA/non AL-CA) on diagnostic thinking and patient management will be assessed with physician’s questionnaires before and after the diagnostic work-up, and after receipt of the PET results

Source: https://euclinicaltrials.eu/ctis-public/view/2022-500186-27-00